EU clinical trial 2024-518773-33-00: SGL-TX-GFR SGLT2i safety and efficacy on kidney allograft function in non-diabetic kidney transplant recipients: A randomized, double-blind, placebo controlled, national, multicenter trial.
Sponsor: Odense University Hospital (Hospital/Clinic/Other health care facility). Phase: Therapeutic use (Phase IV). Countries: Denmark (ongoing, recruiting).
Therapeutic area(s): Not possible to specify
Gender: Female, Male. Age: 18-64 years, 65+ years. Enrolment: 88.
Status: Ongoing, recruiting. Start date (EU): 2025-08-12. Decision date: 2025-06-20. Results received: No. Last updated: 2025-06-20.

Condition(s): Kidney transplant recipients
Product: Forxiga 10 mg film-coated tablets, Placebo Capsules is manufactured by Region Hovedstadens Pharmacy. One placebo tablet (8 mm, white, convex, lactosemonohydrate) is placed into an empty, opaque gelatin capsule, size AA. The capsule is filled with Lactose Monohydrate before being sealed using a manual capsule-filling device. For further information see appendix sIMPD for placebo

Primary endpoint: Chronic eGFR slope (ml/min/1.73m2) measured from week 4, and then every 3 month until 18 month post randomization.
Endpoint(s): Albumin/creatinine ratio (U-ACR) (mg/g), Creatinine (umol/L), Total-Cholesterol, Low-and high-density lipoproteins (LDL and HDL), Triglycerides, Clinical routine Tacrolimus concentration (ug/L), ALAT (U/L), Bilirubin, Pro-BNP, renin, angiotensin-2, aldosterone, Frequence of positive urine cultures, Incidence of Post Transplant Diabetes Mellitus and prediabetes status, Change in volume status in week 1 of therapy (Weight), Incidence of kidney transplant rejection (biopsy verified), Renal composite outcome (Incidence of graft failure (defined as return to dialysis or retransplantation), Incidence of ESRD (defined as eGFR<15 ml/min/1.73m2), Incidence of > 25% increase in creatinine, Change in Systolic blood pressure (SysBP) (mmHg) and diastolic blood pressure (DiaBP) (mmHg), Relative incidence of out-of-target measures of clinical routine blood Tacrolimus levels, Urine biomarkers indicative of podocyt and tubular function from selected sites, Incidence of: Adverse events, Serious adverse events, Serious adverse reactions, Death – all cause mortality, Major Adverse Cardiac Events (MACE)

Source: https://euclinicaltrials.eu/ctis-public/view/2024-518773-33-00